EU clinical trial 2024-516376-15-00: Strategy To Optimize PeriproCeduraL AnticOagulation in Structural Transseptal Interventions (STOP CLOT Trial)
Protocol code: ABM/2020/1/00002
Sponsor: Narodowy Instytut Kardiologii Stefana Kardynala Wyszynskiego Panstwowy Instytut Badawczy (Hospital/Clinic/Other health care facility). Phase: Phase III and phase IV (Integrated). Countries: Poland (authorised, recruitment pending).
Therapeutic area(s): Diseases [C] - Cardiovascular Diseases [C14]
Gender: Female, Male. Age: 18-64 years, 65+ years. Enrolment: 410.
Status: Authorised, recruitment pending. Decision date: 2024-12-09. Results received: No. Last updated: 2026-02-11.

Condition(s): periprocedural anticoagulant treatment in patients treated with TEER or transcatheter left atrial appendage closure surgery
Product: PHYSIOLOGICAL SALINE SOLUTION: Injectio Natrii Chlorati Isotonica Polpharma, 9 mg/ml,, HEPARINUM WZF, 5 000 IU/ml, roztwór do wstrzykiwań

Primary endpoint: The primary efficacy endpoint is a composite of the following: 1 major adverse cardiac and cerebrovascular events (MACCE; death, stroke, transient ischemic attack [TIA], myocardial infarction, or peripheral embolization) within 30 days after procedure; 2 intraprocedural new thrombus formation in the right or left atrium as assessed with periprocedural TEE; or 3 occurrence of new ischemic lesions with diameter ≥4 mm on brain MRI performed 2 to 5 days after the procedure.
Endpoint(s): The secondary/efficacy safety endpoint: moderate or severe bleeding complications (BARC 2-5) including cardiac tamponade requiring intervention during the index hospitalization; 1 intraprocedural new thrombus formation in the right or left atrium as assessed by periprocedural TEE; 2 occurrence of new ischemic brain lesions on MRI performed within 2 to 5 days after the index procedure; or 3 MACCE (death, stroke, TIA, peripheral embolization, myocardial infarction) within 30 days from the index

Source: https://euclinicaltrials.eu/ctis-public/view/2024-516376-15-00